EU clinical trial 2023-507541-29-00: EFFICACY AND SAFETY OF CROMOGLYCATE AS A NEW SYMPTOMATIC TREATMENT IN PATIENTS WITH MULTIPLE SCLEROSIS
Protocol code: CAMINA
Sponsor: Fundacion Para La Investigacion Biomedica Del Hospital Clinico San Carlos (Laboratory/Research/Testing facility). Phase: Therapeutic exploratory (Phase II). Countries: Spain (ongoing, recruitment ended).
Therapeutic area(s): Diseases [C] - Nervous System Diseases [C10]
Gender: Female, Male. Age: 18-64 years. Enrolment: 120.
Status: Ongoing, recruitment ended. Start date (EU): 2024-10-01. Decision date: 2023-12-13. Results received: No. Last updated: 2025-06-30.

Condition(s): Multiple sclerosis
Product: CROMOGLICIC ACID, Placebo

Primary endpoint: Modified Fatigue Impact Scale (MFIS) at the end-of-treatment visit (V4) with respect to baseline., Fatigue Severity Scale (FSS)., Patient-reported outcome measurement information system for fatigue in multiple sclerosis (PROMIS-SF-Fatigue).
Endpoint(s): Actionable Bladder Symptom Screening Tool (ABSST)., Urinary incontinence questionnaire (ICIQ-SF)., Sandvik incontinence severity test., Bladder Control Scale (BLCS)., International Prostate Symptom Scale (IPSS)., Questionnaire on the specific impact of urinary problems on quality of life (Qualiveen), SF-36 quality of life questionnaires., EQ-5D quality of life questionnaire., Hospital Anxiety and Depression Scale (HADS)., Beck Depression Inventory (BDI)., Expanded Disability Status Scale (EDSS)., Test of the 25 steps., Test of the 9 sticks., Time of multiple sclerosis progression., New lesions evaluated by magnetic resonance imaging, Presence of global cerebral atrophy, thalamic atrophy and cortical atrophy, and correlation with changes in fatigue., Presence of mutation 816V c-kit gene, cytokine levels and activation of lymphocyte populations and correlation with changes in fatigue., Axonal damage and macular volume assessed by optical coherence tomography., Modified ASHWORTH scale., Bowel Control Scale (BWCS)., Questionnaire on intimacy and sexuality in MS (MSISQ-19)., Work Productivity and Activity Impairment Scale (WPAI)., Patient symptom scales., Symbols and Digits Test (SDMT)., Perineal and perianal sensitivity., Bulbocavernosus reflex., Anal sphincter tone., In women: presence of prolapses., Postvoid residue., Peak flow in uroflowmetry., Detrusor contractions in cistonanometry., Urination difficulty assessed by flow pressure test (maximum flow)., PAD test value in 24 hours., Voiding diary: Urinated volume, urgency, urine leakage, urge incontinence, stress incontinence, moulting, and drinking., Treatment-related adverse events, Analytical values of complete blood count, biochemistry, hepatorenal and thyroid profile, serum tryptase, urine strip, systematic and urine sediment and pregnancy test., Concomitant medication., Modifying treatment., Modified fatigue impact scale (MFIS) at each treatment visit with respect to baseline.

Source: https://euclinicaltrials.eu/ctis-public/view/2023-507541-29-00